EU clinical trial 2025-522662-67-00: A Trial to Evaluate Pharmacodynamics, Pharmacokinetics, Safety, and Tolerability of Insulin GZR4 Compared with Insulin Degludec and Insulin Icodec in Participants with Type 2 Diabetes
Protocol code: GL-ULI-1001
Sponsor: Gan & Lee Pharmaceuticals USA Corp. (Pharmaceutical company). Phase: Human Pharmacology (Phase I)- Other. Countries: Germany (ongoing, recruiting).
Therapeutic area(s): Diseases [C] - Hormonal diseases [C19]
Gender: Female, Male. Age: 18-64 years, 65+ years. Enrolment: 14.
Status: Ongoing, recruiting. Start date (EU): 2025-08-13. Decision date: 2025-08-06. Results received: No. Last updated: 2025-12-04.

Condition(s): Type 2 Diabetes Mellitus

Source: https://euclinicaltrials.eu/ctis-public/view/2025-522662-67-00